EU clinical trial 2024-514929-33-00: PREPARE - Intrapapillary botulinum toxin injection for PREvention of post-surgical PAncREatic fistula
Protocol code: P170913J
Sponsor: Assistance Publique Hopitaux De Paris (Hospital/Clinic/Other health care facility). Phase: Therapeutic confirmatory (Phase III). Countries: France (ongoing, recruiting).
Therapeutic area(s): Diseases [C] - Digestive System Diseases [C06]
Gender: Female, Male. Age: 18-64 years, 65+ years. Enrolment: 460.
Status: Ongoing, recruiting. Start date (EU): 2023-03-27. Decision date: 2024-10-16. Results received: No. Last updated: 2025-08-01.

Condition(s): PANCREATIC FISTULA
Product: XEOMIN 100 unités, poudre pour solution injectable

Primary endpoint: Clinically relevant POPF (grade B and C) in the 3 months after DP.
Endpoint(s): Grade of postoperative pancreatic fistulas (B, C) based on the ISGPF 2016 update, Biochemical leak after surgery, Postoperative complications: intra-abdominal fluid collection, delayed gastric emptying, hemorrhage, pancreatitis, wound infection, other infectious complication, Clavien-Dindo classification for post-surgical morbidity, Health economics endpoints: duration of hospital stay, hospital readmissions, transfer to intensive care unit and the duration of these stays, fistularelated postoperative invasive procedures, overall costs, the incremental cost utility ratio, the incremental cost effectiveness ratio based upon the clinical endpoint of mortality and post-surgical complication including pancreatic fistula, Quality of life score (EQ5D5L questionnaire), Postsurgical mortality (30 and 90-day), Side effects related to the endoscopic botulinum toxin injection

Source: https://euclinicaltrials.eu/ctis-public/view/2024-514929-33-00